EU clinical trial 2024-517643-31-00: The use of empagliflozin in patients with hypertrophic cardiomyopathy
Protocol code: EMPA-REPAIR-HCM
Sponsor: Narodowy Instytut Kardiologii Stefana Kardynala Wyszynskiego Panstwowy Instytut Badawczy (Hospital/Clinic/Other health care facility). Phase: Therapeutic confirmatory (Phase III). Countries: Poland (ongoing, recruitment ended).
Therapeutic area(s): Diseases [C] - Cardiovascular Diseases [C14]
Gender: Female, Male. Age: 18-64 years, 65+ years. Enrolment: 250.
Status: Ongoing, recruitment ended. Start date (EU): 2022-06-22. Decision date: 2024-11-11. Results received: No. Last updated: 2024-11-11.

Condition(s): Hypertrophic cardiomyopathy
Product: Microcrystalline cellulose, magnesium stearate, Jardiance 10 mg film-coated tablets

Primary endpoint: A test of the null hypothesis that the mean VO 2 max measured 12 months after randomization is the same in the treatment group and the placebo group;, A null hypothesis test that the mean KCCQ-OS value measured 12 months after randomization is the same in the treatment group and the placebo group.
Endpoint(s): The secondary objective of the trial is to test the null hypothesis that the mean value of the VO 2 max measured 12 months after randomization is the same in the treatment group treated group and the placebo group among patients with reduced left ejection fraction ventricle.

Source: https://euclinicaltrials.eu/ctis-public/view/2024-517643-31-00